EU clinical trial 2024-518127-30-00: IMHOTEP : Immunotherapy in MSI/dMMR Tumors in perioperative setting
Protocol code: ET20-093
Sponsor: Centre Leon Berard (Hospital/Clinic/Other health care facility). Phase: Therapeutic exploratory (Phase II). Countries: France (ongoing, recruitment ended).
Therapeutic area(s): Diseases [C] - Neoplasms [C04]
Gender: Female, Male. Age: 18-64 years, 65+ years. Enrolment: 240.
Status: Ongoing, recruitment ended. Start date (EU): 2021-11-26. Decision date: 2024-11-05. Results received: No. Last updated: 2026-03-13.

Condition(s): MSI/dMMR tumors or EBV+ gastric cancer
Product: KEYTRUDA 25 mg/mL concentrate for solution for infusion

Primary endpoint: The primary endpoint will be the rate of complete pathological response (pCR) after surgery according to local pathological evaluation. A complete pathological response will be defined as 0% viable tumor cells in tumor or nodal site (ypT0N0).
Endpoint(s): Safety profile, Rate of surgical complications, Percentage of patients with R0 resection, Percentage of patients with major pathological response, RFS, Percentage of patients with objective response 4, 10, 16 and 21 weeks, Percentage of patients with second cancer in the Lynch syndrome spectrum, OS, PFS, QoL, Association between LIPI score and the response to treatment, In the subgroup of patients without surgery: Progression free survival (PFS),

Source: https://euclinicaltrials.eu/ctis-public/view/2024-518127-30-00